EU clinical trial 2024-516613-21-00: Combined antitumor therapy with ex vivo manipulated dendritic cells producing interleukin-12 in children, adolescents and young adults with progressive, recurrent or primarily metastatic high-risk tumors
Protocol code: KDO_DC1311
Sponsor: Masarykova Univerzita (Educational Institution). Phase: Phase I and Phase II (Integrated)- Other. Countries: Czechia (ended).
Therapeutic area(s): Diseases [C] - Neoplasms [C04]
Gender: Female, Male. Age: 0-17 years, 18-64 years. Enrolment: 52.
Status: Ended. Start date (EU): 2015-09-10. End date (EU): 2024-07-31. Decision date: 2024-11-21. Results received: No. Last updated: 2024-11-21.

Condition(s): Progressive, recurrent or primarily metastatic high-risk paediatric malignancies
Product: Autologous dendritic cell vaccine producing interleukin 12

Primary endpoint: Combined primary endpoint of safety: frequency of events defined by the clinical trial protocol as AESI (adverse events of special interest)
Endpoint(s): Time to progression, Overall survival, Objective response rate (RECIST), Clinical benefit rate (CBR), Frequency of all adverse events assessed in relation to type, seriousness and causality

Source: https://euclinicaltrials.eu/ctis-public/view/2024-516613-21-00